EU clinical trial 2025-522140-40-00: TARGET-EBV in MS: A prospective randomized controlled parallel group phase 2b double blinded study to investigate if targeting Epstein Barr Virus with Tenofovir Alafenamide Fumarate compared to placebo as add-on treatment to anti-CD20 therapy reduces neuronal damage in multiple sclerosis
Sponsor: Oslo University Hospital HF (Hospital/Clinic/Other health care facility). Phase: Therapeutic exploratory (Phase II). Countries: Norway (authorised, recruitment pending).
Therapeutic area(s): Diseases [C] - Nervous System Diseases [C10]; Phenomena and Processes [G] - Immune system processes [G12]; Diseases [C] - Virus Diseases [C02]
Gender: Female, Male. Age: 18-64 years, 65+ years. Enrolment: 60.
Status: Authorised, recruitment pending. Decision date: 2025-08-11. Results received: No. Last updated: 2026-04-10.

Condition(s): multiple sclerosis
Product: TENOFOVIR ALAFENAMIDE, Placebo capules, hard

Primary endpoint: Change in mean cerebrospinal fluid (CSF) Neurofilament light chain level (NfL) between the treatment groups from baseline (week 0) to End of Study (EOS), (week 52).
Endpoint(s): Difference in TSPO binding on PET between the treatment groups from baseline (week 0) to EOS (week 52)., Change in patient reported outcomes of fatigue from baseline (week 0) to EOS (week 52)., Difference in number of PRLs in the treatment groups from baseline (week 0) to EOS (week 52)., Total number of AEs, SAEs and SUSARs, Treatment tolerability

Source: https://euclinicaltrials.eu/ctis-public/view/2025-522140-40-00